EU clinical trial 2024-516220-34-00: A Randomized, Multicentre, Seamless, Adaptive Phase I/II Study to Determine Safety and Efficacy of RhinoPHAGE-2A cocktail in Patients with Chronic Rhinosinusitis Associated with Staphylococcus aureus Infection
Protocol code: Rhinophage-One
Sponsor: Instytut Immunologii I Terapii Doswiadczalnej Im Ludwika Hirszfelda Pan We Wroclawiu (Educational Institution). Phase: Phase I and Phase II (Integrated)- First administration to humans. Countries: Poland (not authorised).
Therapeutic area(s): Diseases [C] - Bacterial Infections and Mycoses [C01]; Diseases [C] - Otorhinolaryngologic Diseases [C09]
Gender: Female, Male. Age: 18-64 years, 65+ years. Enrolment: 600.
Status: Not authorised. Decision date: 2025-04-22. Results received: No. Last updated: 2025-04-22.

Condition(s): Chronic Rhinosinusitis associated with Staphylococcus aureus Infection

Source: https://euclinicaltrials.eu/ctis-public/view/2024-516220-34-00